EU clinical trial 2024-512659-19-00: A Multicenter, Randomized, Double-Blind, Active Comparator-Controlled, Adaptive Phase 2/3 Study to Evaluate the Safety and Efficacy of EIK1001 and Pembrolizumab Versus Placebo and Pembrolizumab as First-Line Therapy in Participants with Advanced Melanoma (TeLuRide-006)
Protocol code: EIK1001-006
Sponsor: Eikon Therapeutics Inc. (Pharmaceutical company). Phase: Phase II and Phase III (Integrated). Countries: Portugal (ongoing, recruiting), Italy (ongoing, recruiting), France (ongoing, recruiting), Germany (ongoing, recruiting), Poland (ongoing, recruiting), Norway (ongoing, recruiting), Finland (ongoing, recruiting), Bulgaria (authorised, recruitment pending), Spain (ongoing, recruiting), Denmark (authorised, recruiting), Austria (authorised, recruiting), Czechia (ongoing, recruiting), Belgium (ongoing, recruiting), Hungary (authorised, recruiting), Sweden (authorised, recruiting).
Therapeutic area(s): Diseases [C] - Neoplasms [C04]
Gender: Female, Male. Age: 0-17 years, 18-64 years, 65+ years. Enrolment: 715.
Start date (EU): 2025-03-31. Decision date: 2024-11-18. Results received: No. Last updated: 2026-01-20.
Decision dates by country: DK: 2024-11-18, BG: 2025-01-15, NO: 2025-01-06, FI: 2025-01-17, SE: 2025-01-15, AT: 2025-01-21, BE: 2025-01-10, DE: 2024-12-02, PT: 2024-11-26, IT: 2024-12-03, CZ: 2024-11-28, HU: 2024-12-20, PL: 2025-01-21, ES: 2025-01-15, FR: 2024-12-03

Condition(s): Advanced Melanoma
Product: PEMBROLIZUMAB, Matching placebo, EIK1001 solution for injection 1.0 mg/mL free base equivalent

Primary endpoint: Objective Response (OR; defined as participants who demonstrate confirmed complete response [CR] or partial response [PR] by Response Evaluation Criteria in Solid Tumors [RECIST] version 1.1 as assessed by the Investigator), adverse events (AEs), and discontinuation of study treatment due to an AE (Dose Optimization)., PFS defined as the time from randomization to documented progressive disease per RECIST 1.1 by BICR or death due to any cause, whichever occurs first., OS defined as the time from randomization to death due to any cause
Endpoint(s): AEs and discontinuation of study treatment due to any AE., OR and DOR; OR defined as participants who demonstrate confirmed CR or PR; DOR defined as the time from the first documented evidence of CR or PR until disease progression or death due to any cause, whichever occurs first, according to RECIST 1.1 by BICR., PFS, OR, and DOR according to RECIST 1.1 by Investigator., DOR per RECIST 1.1 by Investigator (Dose Optimization)., PFS per RECIST 1.1 by Investigator and OS (Dose Optimization).

Source: https://euclinicaltrials.eu/ctis-public/view/2024-512659-19-00